EU clinical trial 2025-524852-74-00: A clinical trial of MK-3214 taken with different liquids in healthy participants (MK-3214-002)
Protocol code: MK-3214-002
Sponsor: Merck Sharp & Dohme LLC (Pharmaceutical company). Phase: Human Pharmacology (Phase I)- Other. Countries: Belgium (ended).
Therapeutic area(s): Diseases [C] - Cardiovascular Diseases [C14]
Gender: Male. Age: 18-64 years. Enrolment: 32.
Status: Ended. Start date (EU): 2026-03-11. End date (EU): 2026-06-02. End date: 2026-06-03. Decision date: 2026-03-06. Results received: No. Last updated: 2026-03-06.

Condition(s): Hypercholesterolaemia

Source: https://euclinicaltrials.eu/ctis-public/view/2025-524852-74-00